EU clinical trial 2026-526444-13-01: Preventing urinary tract infections in infants and young children with probiotic E. coli Nissle: FinNissle randomized controlled trial
Sponsor: Pohjois-Pohjanmaan hyvinvointialue (Hospital/Clinic/Other health care facility). Phase: Therapeutic confirmatory (Phase III). Countries: Finland (authorised, recruitment pending).
Therapeutic area(s): Diseases [C] - Bacterial Infections and Mycoses [C01]
Gender: Female, Male. Age: 0-17 years. Enrolment: 250.
Status: Authorised, recruitment pending. Decision date: 2026-07-10. Results received: No. Last updated: 2026-07-10.

Condition(s): Urinary tract infection or Pyelonephritis
Product: Mutaflor 10^8 CFU/ml oraalisuspensio, • Alternative 1 (DF-2004 standard): Sucrose 630 mg/g, Purified Water (Aqua purificata) 370 mg/g. • Alternative 2 (DAB standard): Sucrose (Saccharum) 640 mg/g, Purified Water (Aqua purificata) 360 mg/g.

Primary endpoint: The proportion of children with a recurrent UTI during 6-month follow up.
Endpoint(s): Number of culture-confirmed UTIs per person-years at risk (PYR), Number of hospitalization days due to UTIs, Number of days of antibiotic treatment for suspected/confirmed UTIs after the initial study entry antibiotics end, Number of days of antibiotic treatment for any reason after initial antibiotics end, Number of days the child experienced abdominal pain, Number of days the child experienced diarrhoea

Source: https://euclinicaltrials.eu/ctis-public/view/2026-526444-13-01